EU clinical trial 2025-521780-12-00: Withdrawal of neurohormonal therapy in patients with non-ischemic cardiomyopathy, no late gadolinium enhancement, and negative genetic testing, who have exhibited super-response to cardiac resynchronization therapy. DRUGLESS-CRT clinical trial.
Protocol code: DRUGLESS-CRT
Sponsor: Andrea Di Marco (Hospital/Clinic/Other health care facility). Phase: Phase III and phase IV (Integrated). Countries: Spain (authorised, recruiting).
Therapeutic area(s): Diseases [C] - Cardiovascular Diseases [C14]
Gender: Female, Male. Age: 18-64 years, 65+ years. Enrolment: 64.
Status: Authorised, recruiting. Start date (EU): 2025-12-16. Decision date: 2025-10-28. Results received: No. Last updated: 2025-12-05.

Condition(s): Non-ischemic cardiomyopathy
Product: ATENOLOL, DAPAGLIFLOZIN, METOPROLOL, EMPAGLIFLOZIN, NEBIVOLOL, EPLERENONE, PROPRANOLOL, VALSARTAN AND SACUBITRIL, SPIRONOLACTONE, LOSARTAN, LISINOPRIL, ENALAPRIL, RAMIPRIL, CANDESARTAN, IRBESARTAN, BISOPROLOL, VALSARTAN, TELMISARTAN, CAPTOPRIL, CARVEDILOL

Primary endpoint: Recurrence of left ventricular dysfunction or heart failure at 6 months (any of the following events): Decrease in LVEF >10% and LVEF <50% or; decrease in LVEF >10% and an increase in the left ventricular end-systolic volume >15% or; onset of heart failure symptoms accompanied by an elevation in NT-proBNP requiring initiation of treatment with oral, subcutaneous, or intravenous loop diuretic therapy.
Endpoint(s): Emergency or day care hospital visits for heart failure at 6 and 12 months, Hospital admissions for heart failure at 6 and 12 months, Ventricular arrhythmias at 6 and 12 months, Supraventricular arrhythmias at 6 and 12 months, NT-proBNP levels at 6 and 12 months, NYHA class at 6 and 12 months, Quality of life at 6 and 12 months, Recurrence of left ventricular dysfunction or heart failure (as defined for the primary endpoint) at 12 months.

Source: https://euclinicaltrials.eu/ctis-public/view/2025-521780-12-00